EU clinical trial 2025-521101-40-00: GLIFLOFASTER : EARLY GLIFLOZIN TREATMENT IN ELDERLY PATIENT HOSPITALIZED FOR DECOMPENSATED CHRONIC HEART FAILURE ADMITTED IN THE EMERGENCY ROOM - A FEASIBILITY STUDY
Protocol code: 2024/882
Sponsor: Centre Hospitalier Regional Universitaire (Hospital/Clinic/Other health care facility). Phase: Therapeutic use (Phase IV). Countries: France (authorised, recruitment pending).
Therapeutic area(s): Diseases [C] - Cardiovascular Diseases [C14]
Gender: Female, Male. Age: 65+ years. Enrolment: 144.
Status: Authorised, recruitment pending. Decision date: 2026-03-31. Results received: No. Last updated: 2026-03-31.

Condition(s): CHRONIC DECOMPENSATED HEART FAILURE
Product: DAPAGLIFLOZIN PROPANEDIOL MONOHYDRATE

Primary endpoint: Organizational feasibility: setting up procedures, distribution of subjects in the flow chart. Acceptability based on refusal characteristics: number and reason. Adherence to the protocol and treatment: attrition, completeness of emergency CRF and IPA completion, proportion of patients contacted by telephone, compliance with the treatment and follow-up regimen. Compliance with the provisional timeline for the implementation of the study
Endpoint(s): A composite endpoint comprising the following at 3 months: - All-cause mortality - Rehospitalization or unplanned visit for CHF - Deterioration in quality of life: 5-point decrease after 3 months of treatment compared to the value measured at hospital discharge (KCCQ-12), Each of the three criteria of the composite criterion taken individually, A 50% decrease in NT-proBNP levels at 7 days (or upon discharge from hospital if earlier than 7 days) and at 3 months, Regression of clinical signs (dyspnea, asthenia, congestive signs) at 7 days (or upon discharge from hospital if earlier than 7 days) and at 3 months, Tolerance in relation to renal function: difference between glomerular filtration rate relative to baseline (at randomization) at 7 days (or at hospital discharge if earlier than 7 days) and at 3 months.

Source: https://euclinicaltrials.eu/ctis-public/view/2025-521101-40-00